EU clinical trial 2023-506063-34-00: A Phase I Study of Belantamab Mafodotin in Multiple Myeloma Participants with Normal and Impaired Renal Function
Protocol code: 209626 (DreaMM 12)
Sponsor: Glaxosmithkline Research & Development Limited (Pharmaceutical company). Phase: Human Pharmacology (Phase I)- Other. Countries: Greece (ongoing, recruitment ended).
Therapeutic area(s): Diseases [C] - Neoplasms [C04]
Gender: Female, Male. Age: 18-64 years, 65+ years. Enrolment: 9.
Status: Ongoing, recruitment ended. Start date (EU): 2021-07-23. Decision date: 2024-01-26. Results received: No. Last updated: 2026-05-20.

Condition(s): Relapsed/Refractory Multiple Myeloma

Source: https://euclinicaltrials.eu/ctis-public/view/2023-506063-34-00